EU clinical trial 2024-516525-31-01: AFFIRM: A Randomized, Double-Blind, Placebo-Controlled, Study to Evaluate the Effect of Seladelpar on Clinical Outcomes in Patients with Primary Biliary Cholangitis (PBC) and Compensated Cirrhosis
Protocol code: CB8025-41837
Sponsor: Gilead Sciences Inc. (Pharmaceutical company). Phase: Therapeutic confirmatory (Phase III). Countries: Germany (authorised, recruiting), Italy (ongoing, recruiting), France (ongoing, recruiting), Hungary (authorised, recruiting), Greece (authorised, recruiting), Czechia (ongoing, recruiting), Spain (ongoing, recruiting), Poland (ongoing, recruiting), Austria (ongoing, recruiting), Belgium (ongoing, recruiting), Romania (ongoing, recruiting), Denmark (ongoing, recruiting), Portugal (authorised, recruitment pending).
Therapeutic area(s): Diseases [C] - Digestive System Diseases [C06]
Gender: Female, Male. Age: 18-64 years, 65+ years. Enrolment: 118.
Start date (EU): 2025-07-14. Decision date: 2025-06-23. Results received: No. Last updated: 2026-05-07.
Decision dates by country: GR: 2025-06-25, CZ: 2025-06-26, ES: 2025-06-27, HU: 2025-06-27, PL: 2025-06-30, BE: 2025-06-24, AT: 2025-06-29, RO: 2025-06-30, IT: 2025-06-24, FR: 2025-06-23, DE: 2025-06-25, DK: 2025-07-04, PT: 2026-05-07

Condition(s): Primary Biliary Cholangitis
Product: Placebo to match 10 mg, Placebo to match 5 mg

Primary endpoint: EFS as measured by the time from start of treatment to the first occurrence of any of the following adjudicated events up to week 156: a. Death by any cause b. Liver transplantation c. MELD Score ≥ 15 d. Ascites requiring treatment e. Hospitalization for any of the following qualifying events: i.Esophageal or gastric variceal bleeding ii.Hepatic encephalopathy iii. Spontaneous bacterial peritonitis
Endpoint(s): Overall survival, defined as time from start of treatment to death from any cause up to Week 156, LTFS, defined as time from start of treatment to the first occurrence of any of the following up to Week 156: a. Liver-related death b. Liver transplantation, Time to hospitalization for qualifying PBC clinical events from start of treatment up to Week 156:, Time to each of the other adjudicated PBC clinical events from start of treatment up to Week 156: a. MELD Score ≥ 15 b. Ascites requiring treatment

Source: https://euclinicaltrials.eu/ctis-public/view/2024-516525-31-01